EU clinical trial 2024-519394-19-00: Measurable residual disease driven strategy for one or two infusions of nonviral, transposon-manipulated CARCIK CD19 cells. A Phase II study in pediatric and adult patients with relapsed/refractory B cell precursor ALL (BCP-ALL).
Sponsor: Fondazione Tettamanti (Laboratory/Research/Testing facility). Phase: Therapeutic exploratory (Phase II). Countries: Italy (ended).
Therapeutic area(s): Diseases [C] - Hemic and Lymphatic Diseases [C15]
Gender: Female, Male. Age: 0-17 years, 18-64 years, 65+ years. Enrolment: 33.
Status: Ended. Start date (EU): 2021-09-22. End date (EU): 2025-05-13. Decision date: 2024-12-10. Results received: No. Last updated: 2025-07-31.

Condition(s): B cell precursor Acute Lymphoblastic Leukemia
Product: PTG-CARCIK-CD19

Primary endpoint: ORR at 28 days after the first CARCIK-CD19 administration, DOR from day 70 for patients who achieved and maintained remission after the first or the second CARCIK-CD19 administration
Endpoint(s): Overall survival (i. e. time from infusion to death), Safety of the second administration of allogeneic CARCIK-CD19 cells, Safety of autologous CARCIK-CD19 cells, Safety of cordblood CARCIK-CD19 cells.

Source: https://euclinicaltrials.eu/ctis-public/view/2024-519394-19-00